EU clinical trial 2022-501973-37-00: A Phase 3, Randomized, Double-Blind Study of Pembrolizumab versus Placebo in Combination With Adjuvant Chemotherapy With or Without Radiotherapy for the Treatment of Newly Diagnosed High-Risk Endometrial Cancer After Surgery With Curative Intent (KEYNOTE-B21 / ENGOT-en11 / GOG-3053)
Protocol code: MK-3475-B21
Sponsor: Merck Sharp & Dohme LLC (Pharmaceutical company). Phase: Therapeutic confirmatory (Phase III). Countries: Norway (ongoing, recruitment ended), Spain (ongoing, recruitment ended), Belgium (ongoing, recruitment ended), Finland (ongoing, recruitment ended), Austria (ongoing, recruitment ended), Denmark (ongoing, recruitment ended), Sweden (ongoing, recruitment ended), Czechia (ongoing, recruitment ended), Germany (ongoing, recruitment ended), France (ongoing, recruitment ended), Italy (ongoing, recruitment ended), Greece (ongoing, recruitment ended), Poland (ongoing, recruitment ended).
Therapeutic area(s): Diseases [C] - Neoplasms [C04]
Gender: Female. Age: 18-64 years, 65+ years. Enrolment: 300.
Status: Ongoing, recruitment ended. Start date (EU): 2020-01-30. Decision date: 2023-08-07. Results received: No. Last updated: 2026-07-10.
Decision dates by country: PL: 2023-10-17, SE: 2023-08-07, NO: 2023-08-14, FI: 2023-08-14, IT: 2023-09-13, CZ: 2023-08-08, GR: 2023-09-13, AT: 2023-08-14, DK: 2023-08-07, BE: 2023-08-07, FR: 2023-09-11, ES: 2023-08-11, DE: 2023-08-18

Condition(s): Endometrial cancer
Product: Placebo for Pembrolizumab, PACLITAXEL, DOCETAXEL, CARBOPLATIN, CISPLATIN, KEYTRUDA 25 mg/mL concentrate for solution for infusion

Primary endpoint: Disease-Free Survival (DFS) as Assessed Radiographically by Investigator or by Histopathologic Confirmation of Suspected Disease Recurrence, Overall Survival (OS)
Endpoint(s): Disease-Free Survival (DFS) as Assessed Radiographically by Blinded Independent Central Review (BICR) or by Histopathologic Confirmation of Suspected Disease Recurrence, Disease-Free Survival (DFS) as Assessed Radiographically by Investigator or by Histopathologic Confirmation of Suspected Disease Recurrence by Combined Positivity Score (CPS)-Determined Programmed Cell Death 1 Ligand 1 (PD-L1) Status, Overall Survival (OS) as Assessed Radiographically by Investigator or by Histopathologic Confirmation of Suspected Disease Recurrence by Combined Positivity Score (CPS)-Determined Programmed Cell Death 1 Ligand 1 (PD-L1) Status, Disease-Free Survival (DFS) as Assessed Radiographically by Investigator or by Histopathologic Confirmation of Suspected Disease Recurrence by Tumor Mutation Burden (TMB) Status, Overall Survival (OS) as Assessed Radiographically by Investigator or by Histopathologic Confirmation of Suspected Disease Recurrence by Tumor Mutation Burden (TMB) Status, Number of Participants Who Experience One or More Adverse Events (AEs), Number of Participants Who Discontinue Study Treatment Due to an Adverse Event (AE), Change from Baseline in European Organization for Research and Treatment of Cancer Quality of Life Questionnaire (EORTC QLQ-C30) Global Health Status/Quality of Life (QoL) Score, Change from Baseline in European Organization for Research and Treatment of Cancer Quality of Life Questionnaire (EORTC QLQ-C30) Physical Function Score, Change from Baseline in European Organization for Research and Treatment of Cancer Quality of Life Questionnaire Symptom Specific Scale for Endometrial Cancer (EORTC QLQ-EN24) Score

Source: https://euclinicaltrials.eu/ctis-public/view/2022-501973-37-00